EU clinical trial 2024-519749-31-00: Comparative study of eplerenone-based treatment strategy versus irbesartan-based blood pressure lowering in obese hypertensive patients (HEBRO Study)
Protocol code: HEBRO-001
Sponsor: Institute For Study Research Education And Therapy Of Vascular Heart Brain And Kidney Nosologies (Educational Institution). Phase: Therapeutic use (Phase IV). Countries: Greece (authorised, recruitment pending).
Therapeutic area(s): Diseases [C] - Cardiovascular Diseases [C14]
Gender: Female, Male. Age: 18-64 years. Enrolment: 198.
Status: Authorised, recruitment pending. Decision date: 2025-01-21. Results received: No. Last updated: 2025-01-21.

Condition(s): Hypertension
Product: Fludex 1,5 mg, επικαλυμμένα με λεπτό υμένιο δισκία παρατεταμένης αποδέσμευσης., LUCIDEL 150 mg επικαλυμμένα με λεπτό υμένιο δισκία., Amlopen® 5mg καψάκια σκληρά, Inosamin 25mg, επικαλυμμένα με λεπτό υμένιο δισκία

Primary endpoint: Η διαφορά της 24ωρης περιπατητικής αρτηριακής πίεσης στο σκέλος της επλερενόνης έναντι του σκέλους της ιρβεσαρτάνης στις 24 εβδομάδες παρακολούθησης σε σχέση με τις 0 εβδομάδες.
Endpoint(s): Η διαφορά της 24ωρης περιπατητικής αρτηριακής πίεσης στο σκέλος της επλερενόνης έναντι του σκέλους της ιρβεσαρτάνης στις 8 και 16 εβδομάδες παρακολούθησης σε σχέση με τις 0 εβδομάδες., Η διαφορά της αρτηριακής πίεσης ιατρείου σε διάστημα 8, 16 και 24 εβδομάδων παρακολούθησης σε σχέση με τις 0 εβδομάδες., Το ποσοστό ρύθμισης της αρτηριακής πίεσης σε διάστημα 8, 16 και 24 εβδομάδων παρακολούθησης.

Source: https://euclinicaltrials.eu/ctis-public/view/2024-519749-31-00